EU clinical trial 2023-504826-21-00: Phase 2a, double-blind, randomized, placebo-controlled trial of methylprednisolone versus placebo in patients with cognitive deficits in post-COVID-19 syndrome (PCS) - PoCoVIT
Protocol code: PoCoVIT
Sponsor: Charite Universitaetsmedizin Berlin KöR (Hospital/Clinic/Other health care facility). Phase: Therapeutic exploratory (Phase II). Countries: Germany (ended).
Therapeutic area(s): Not possible to specify
Gender: Female, Male. Age: 18-64 years, 65+ years. Enrolment: 418.
Status: Ended. Start date (EU): 2024-07-02. End date (EU): 2025-03-25. Decision date: 2023-06-21. Results received: Yes. Last updated: 2024-11-13.

Condition(s): Post COVID-19 Syndrome
Product: Methylprednisolon 16 mg JENAPHARM®, P-Tabletten weiß 7 mm Lichtenstein

Primary endpoint: to show an intra-patient change in MMQ, subdomain memory satisfaction by ≥15 points from baseline to week 8
Endpoint(s): Intra-patient change in MMQ subdomain memory satisfaction from baseline to week 20, from week 8 to week 20 and from week 20 to week 52, Mean difference in MMQ subdomain ‘memory ability’ from baseline to week 8 and to week 20 and from week 8 to week 20 Mean difference in MMQ subdomain ‘memory strategy’ to week 8 and to week 20 and from week 8 to week 20, Intra-patient change in neuro-psychological and cognitive scores (MoCA, neuropsychological test battery, SDMT) from baseline to week 8 and to week 20 and from week 8 to week 20, Intra-patient change in quantified PROMIS questionnaire and SF-36 from baseline to week 8 and to week 20 and to week 52 and from week 8 to week 20, Intra-patient change in fatigue scores (FSS, Chandler Fatigue Scale) and mood (BDI) from baseline to week 8

Source: https://euclinicaltrials.eu/ctis-public/view/2023-504826-21-00